EU clinical trial 2025-520616-33-00: A study comparing different RO7269162 capsules and investigating the effect of food on the uptake, breakdown, and elimination of RO7269162 in Healthy Participants
Protocol code: BP46028
Sponsor: F. Hoffmann-La Roche AG (Pharmaceutical company). Phase: Human Pharmacology (Phase I)- Other. Countries: Netherlands (ended).
Therapeutic area(s): Health Care [N] - Population Characteristics [N01]; Not possible to specify
Gender: Female, Male. Age: 18-64 years. Enrolment: 48.
Status: Ended. Start date (EU): 2025-09-02. End date (EU): 2025-11-10. End date: 2025-11-11. Decision date: 2025-08-29. Results received: No. Last updated: 2025-08-29.

Source: https://euclinicaltrials.eu/ctis-public/view/2025-520616-33-00